EU clinical trial 2025-520705-12-00: A Phase 2, multinational, multicenter, randomized, double-blind, placebo-controlled, dose-ranging study to evaluate the efficacy and safety of SAR441566 in adults with moderate-to-severe ulcerative colitis
Protocol code: DRI17822
Sponsor: Sanofi-Aventis Recherche & Developpement (Pharmaceutical company). Phase: Therapeutic exploratory (Phase II). Countries: Croatia (ended), Romania (ended), Greece (ongoing, recruitment ended), Italy (ongoing, recruitment ended), Belgium (ongoing, recruitment ended), Germany (ongoing, recruitment ended), Hungary (ongoing, recruitment ended), Czechia (ongoing, recruitment ended), Poland (ongoing, recruitment ended), France (ongoing, recruitment ended), Bulgaria (ended), Austria (ongoing, recruitment ended).
Therapeutic area(s): Diseases [C] - Digestive System Diseases [C06]
Gender: Female, Male. Age: 18-64 years, 65+ years. Enrolment: 178.
Start date (EU): 2025-06-24. Decision date: 2025-06-03. Results received: No. Last updated: 2026-06-30.
Decision dates by country: AT: 2025-06-11, BE: 2025-06-04, BG: 2025-06-09, HR: 2025-06-13, CZ: 2025-06-09, FR: 2025-06-03, GR: 2025-06-04, HU: 2025-06-12, IT: 2025-06-11, RO: 2025-06-16, PL: 2025-06-13, DE: 2025-06-03

Condition(s): Colitis Ulcerative
Product: Not the same excipients as Test, Balinatunfib

Primary endpoint: Proportion of participants achieving clinical remission at Week 12 by modified Mayo Score (mMS)
Endpoint(s): Proportion of participants achieving clinical response at Week 12 by modified Mayo Score (mMS), Proportion of participants achieving clinical response at Week 12 by full Mayo score (MS), Proportion of participants achieving clinical remission at Week 12 by full Mayo score (MS), Proportion of participants achieving the combination of patient-reported outcome 2 (PRO2) remission and endoscopic remission at Week 12, Proportion of participants achieving endoscopic remission at Week 12, Change from baseline in PRO2 from randomization to Week 12, Proportion of participants achieving endoscopic response at Week 12, Proportion of participants achieving endoscopic improvement at Week 12, Proportion of participants achieving HEMI at Week 12, Plasma predose concentrations of SAR441566 at selected visits, Plasma postdose concentrations of SAR441566 at selected visits, Number of participants with any treatment-emergent adverse events (TEAEs) during induction and maintenance treatment period, Number of participants with any reatment-emergent adverse events (TEAEs) during open-label treatment period, Proportion achieving Inflammatory Bowel Disease Questionnaire (IBDQ) remission at Week 12, Proportion of participants achieving Inflammatory Bowel Disease Questionnaire (IBDQ) response at Week 12

Source: https://euclinicaltrials.eu/ctis-public/view/2025-520705-12-00